EU clinical trial 2025-524921-42-00: A three-part first-in-human trial to assess safety, tolerability, pharmacokinetics and pharmacodynamics of GUB-UCN2 in healthy lean and obese participants and participants with T2D
Protocol code: GUB-UCN2
Sponsor: Gubra A/S (Pharmaceutical company). Phase: Human Pharmacology (Phase I)- First administration to humans. Countries: Germany (ongoing, recruiting).
Therapeutic area(s): Diseases [C] - Nutritional and Metabolic Diseases [C18]
Gender: Female, Male. Age: 18-64 years, 65+ years. Enrolment: 220.
Status: Ongoing, recruiting. Start date (EU): 2026-07-27. Decision date: 2026-05-11. Results received: No. Last updated: 2026-07-02.

Condition(s): Type 2 Diabetes, Obesity

Source: https://euclinicaltrials.eu/ctis-public/view/2025-524921-42-00